EU clinical trial 2024-510723-18-00: Allogeneic adipose tissue-derived Mesenchymal stromal cells for the treatment of chronic-active antibody mediated rejection in Kidney transplant recipients
Sponsor: Region Midtjylland (Hospital/Clinic/Other health care facility). Phase: Phase I and Phase II (Integrated)- First administration to humans. Countries: Denmark (authorised, recruitment pending).
Therapeutic area(s): Diseases [C] - Immune System Diseases [C20]
Gender: Female, Male. Age: 18-64 years, 65+ years. Enrolment: 10.
Status: Authorised, recruitment pending. Decision date: 2026-03-09. Results received: No. Last updated: 2026-03-09.

Condition(s): Chronic active antibody mediated rejection
Product: MSC, adipose tissue

Primary endpoint: 1. Feasibility: number of participants treated with MSC infusion 2. Safety: number of participants without infusional toxicity 3. Clinical: number of participants without graftloss/death/nephrectomy
Endpoint(s): 1. Kidney function assessment: change in eGFR from before MSC infusion to after. 2. Chronic kidney rejection/damage assessment: change in kidney biopsy/histology, imaging and urinary findings from before MSC infusion to after. 3. Adverse events assessment: number of grade 3 or higher AEs attributable to MSC infusion 4. Anti-donor immune response assessments: changes in DSAs, immune cells and inflammation markers from before MSC infusion to after. 5.Opportunistic infection assessment: changes in

Source: https://euclinicaltrials.eu/ctis-public/view/2024-510723-18-00